EU clinical trial 2024-516788-96-00: Exploratory Study of CAPEcitabine pharmacokinetics and hand-foot syndrome in CES1 variant carriers: the ESCAPE study
Sponsor: Erasmus Universitair Medisch Centrum Rotterdam (Erasmus MC) (Hospital/Clinic/Other health care facility). Phase: Therapeutic use (Phase IV). Countries: Netherlands (ongoing, recruiting).
Therapeutic area(s): Diseases [C] - Neoplasms [C04]
Gender: Female, Male. Age: 18-64 years, 65+ years. Enrolment: 66.
Status: Ongoing, recruiting. Start date (EU): 2025-01-20. Decision date: 2024-10-14. Results received: No. Last updated: 2025-12-15.

Condition(s): Locally advanced or metastatic gastro-intestinal carcinoma
Product: OXALIPLATIN, CAPECITABINE

Primary endpoint: • Difference in AUC0-6 of 5-FU among carriers vs wildtypes for CES1 1165–33 C>A (rs2244613) on C1D14
Endpoint(s): Difference in AUC0-6 of capecitabine and its metabolites besides 5-FU (e.g. capecitabine, 5DFCR, 5DFUR, DHFU, FBAL and FAC) among carriers vs wildtypes for CES1 1165–33 C>A (rs2244613) on C1D14, Differences in concentrations of 5-FU and other metabolites in dermal biopsies and urine among carriers vs wildtypes for CES1 1165–33 C>A (rs2244613) on C1D14, Genotyping of SNPs in genes related to the metabolic pathway of capecitabine (including but not limited to CES1, CES2, CDA, TP, DPYD, DPYS, PPAR-delta), in association with PK and toxicity, Incidence of toxicity for the respective subgroups, HFS-14 questionnaire scores, Differences in the pharmacokinetics of oxaliplatin, in relation with pharmacogenetics and the development of toxicity using plasm concentrations measured on C1D1 (post-infusion) and on C1D14

Source: https://euclinicaltrials.eu/ctis-public/view/2024-516788-96-00